EU clinical trial 2024-519121-38-01: A phase 1 first-in-human study of a phenylalanine-binding polymer (phelimin) in healthy volunteers and adult, classical PKU patients
Protocol code: SMR-4023
Sponsor: Mipsalus ApS (Pharmaceutical company). Phase: Human Pharmacology (Phase I)- First administration to humans. Countries: Denmark (authorised, recruitment pending).
Therapeutic area(s): Diseases [C] - Nutritional and Metabolic Diseases [C18]
Gender: Male. Age: 18-64 years. Enrolment: 7.
Status: Authorised, recruitment pending. Decision date: 2026-06-17. Results received: No. Last updated: 2026-06-17.

Condition(s): Phenylketonuria

Source: https://euclinicaltrials.eu/ctis-public/view/2024-519121-38-01